EU clinical trial 2024-514444-87-00: “Pilot, open, non-comparative study to evaluate the safety and efficacy of Factor-Rich Plasma Intraovarian Growth in Patients with Low Reserve Ovarian”
Protocol code: URA-PRGF-01
Sponsor: Instituto De Investigacion Sanitaria Fundacion Jimenez Diaz (Laboratory/Research/Testing facility). Phase: Therapeutic exploratory (Phase II). Countries: Spain (ongoing, recruiting).
Therapeutic area(s): Phenomena and Processes [G] - Reproductive and Urinary Physiological Phenomena [G08]
Gender: Female. Age: 18-64 years. Enrolment: 50.
Status: Ongoing, recruiting. Start date (EU): 2025-05-29. Decision date: 2024-10-24. Results received: No. Last updated: 2026-04-28.
Decision dates by country: ES: 2024-11-13

Condition(s): Low Reserve Ovarian
Product: Plasma rich in growth factors

Primary endpoint: Compare ovarian reserve markers before and after surgery. intervention: FSH (continuous quantitative variable); LH (continuous quantitative variable); Estradiol (continuous quantitative variable); AMH (continuous quantitative variable); RFA (discrete quantitative variable), Compare results obtained in the IVF-ICSI laboratory before and after PRP infusion: Number of canceled pre-puncture cycles; Number of cycles canceled post-puncture; Number of oocytes recovered; Number of MII on the day of puncture; Number of fertilized oocytes; Number of embryos achieved per EOC cycles; Number of good quality embryos (quality A or B depending ASEBIR classification); Number of frozen embryos
Endpoint(s): Compare pregnancy rates and collect pre-post treatment pregnancy-related complications:Number of pregnancies per cycle started; Number of pregnancies per transfer; Number of abortions; Frequency of twin pregnancy; Frequency of hemoperitoneum; Frequency of post-puncture infection, Endpoints necessary by testing the hypothesis: Causes of sterility; Time of sterility in years; Number of embryos transferred (1 or 2); Stage of transferred embryos; EOC days; Total dose of gonadotropins

Source: https://euclinicaltrials.eu/ctis-public/view/2024-514444-87-00